EU clinical trial 2025-522370-36-00: A Phase 2b, Randomized, Double-blind, Placebo-controlled, Parallel-group, Multicenter, Dose-ranging Study With an Open-label Period Investigating the Efficacy and Safety Profile of KT-621 Administered Orally to Participants with Moderate to Severe Atopic Dermatitis
Protocol code: KT621-AD-201
Sponsor: Kymera Therapeutics Inc. (Pharmaceutical company). Phase: Therapeutic exploratory (Phase II). Countries: Czechia (ongoing, recruitment ended), Germany (ongoing, recruitment ended), Poland (ongoing, recruitment ended).
Therapeutic area(s): Diseases [C] - Skin and Connective Tissue Diseases [C17]
Gender: Female, Male. Age: 0-17 years, 18-64 years, 65+ years. Enrolment: 108.
Status: Ongoing, recruitment ended. Start date (EU): 2026-02-02. Decision date: 2026-01-13. Results received: No. Last updated: 2026-06-26.
Decision dates by country: DE: 2026-01-13, CZ: 2026-01-13, PL: 2026-01-19

Condition(s): Moderate to Severe Atopic Dermatitis
Product: KT-621, KT-621, The placebo is used in the Double-blind, Placebo-controlled (DBPC) Treatment Period. Participants are randomly assigned to receive either KT-621 or a matching placebo. The placebo is designed to match the study drug in appearance and administration method to maintain blinding., KT-621

Primary endpoint: • Percentage change from baseline to Week 16 in the EASI score
Endpoint(s): • Proportion of participants with EASI-50, EASI-75, and EASI-90 at Week 16, • Proportion of participants who achieve a vIGA-AD score of 0 to 1 (on a 5-point scale) and a reduction from baseline of at least 2 points at Week 16, • Proportion of participants with at least a 4-point improvement in the Peak Pruritus NRS at Week 16, •Incidence of TEAEs through Week 16, • Incidence of treatment-emergent SAEs through Week 16, • Incidence of TEAEs from Week 16 through Week 68, • Incidence of treatment-emergent SAEs from Week 16 through Week 68, • Plasma PK parameter estimates of KT-621 derived from plasma concentration time data to Week 16 and Week 68

Source: https://euclinicaltrials.eu/ctis-public/view/2025-522370-36-00